EU clinical trial 2024-519112-14-00: Intervertebral Disc REgeneration mediated by Autologous Mesenchymal stem/stromal cells intradiscal injection: a phase IIB randomized clinical trial
Protocol code: DREAM-GR-2018-12367
Sponsor: Fondazione Policlinico Universitario Campus Bio-medico In Forma A Bbreviata Fon (Hospital/Clinic/Other health care facility). Phase: Therapeutic exploratory (Phase II). Countries: Italy (ended).
Therapeutic area(s): Analytical, Diagnostic and Therapeutic Techniques and Equipment [E] - Therapeutics [E02]
Gender: Female, Male. Age: 18-64 years. Enrolment: 52.
Status: Ended. Start date (EU): 2025-02-13. End date (EU): 2025-10-31. Decision date: 2025-02-13. Results received: No. Last updated: 2025-11-20.

Condition(s): low back pain
Product: LIMBAL STEM CELLS, AUTOLOGOUS

Primary endpoint: To evaluate the efficacy of intradiscal injection of autologous BM-MSC using the visual analog scale (VAS) and functional status assessed by the Oswestry disability index (ODI) after 12 months of treatment, defining responders in case of at least 30% improvement in VAS or ODI at month 12 compared to baseline.
Endpoint(s): To evaluate changes of the treated IVD induced by regenerative therapy by quantitative Magnetic Resonance Imaging (MRI) signal measurements in T2 between baseline and 1, 3, 6 and 12 months, To evaluate modification of disability (ODI) and pain relief (VAS) considered as continuos measures, between baseline and 1, 3 and 6 months. • To evaluate modification of quality of life (SF-36 scores) and work ability index (WAI) considered as continuos measures, between baseline and 1, 3, 6 and 12 months., Safety and tolerability will be evaluated by recording adverse events (AEs) and serious AEs (SAEs) throughout the study till 12 months. Number of participants with adverse events, the correlation of the AE to the IMP and their severity will be used as a measure of safety and tolerability, To evaluate consumption of medications to relieve pain such as type and dose of analgesics will be evaluated. Paracetamol (acetaminophen) and levels 2 analgesics will be assessed throughout the study at each visit

Source: https://euclinicaltrials.eu/ctis-public/view/2024-519112-14-00